EU clinical trial 2023-505102-42-00: A Single-Arm Open-Label Multi-Centre Extension Study of Pertuzumab Administered as a Single Agent or in Combination with other Anti-Cancer Therapies in Patients Previously Enrolled in a Hoffmann-La Roche-Sponsored Pertuzumab Study
Protocol code: MO29406
Sponsor: F. Hoffmann-La Roche AG (Pharmaceutical company). Phase: Therapeutic confirmatory (Phase III). Countries: Portugal (ongoing, recruitment ended), Italy (ongoing, recruitment ended), Spain (ended).
Therapeutic area(s): Diseases [C] - Neoplasms [C04]
Gender: Female, Male. Age: 18-64 years, 65+ years. Enrolment: 23.
Start date (EU): 2014-12-18. Decision date: 2024-06-17. Results received: No. Last updated: 2026-03-20.
Decision dates by country: ES: 2024-06-20, PT: 2024-06-17, IT: 2024-06-24

Condition(s): Solid Malignant Tumors
Product: Herceptin 150 mg powder for concentrate for solution for infusion, Perjeta 420 mg concentrate for solution for infusion

Primary endpoint: AEs, serious adverse events (SAEs), AEs leading to pertuzumab discontinuation or dose interruption, and non-serious AEs of special interest (AESIs) Adverse events will be classified according to the National Cancer Institute [NCI] Common Terminology Criteria for Adverse Events [CTCAE]
Endpoint(s): 1. Assessments of Progression free survival (PFS) will be done per Investigator’s assessment, based on local institution’s standard of care, 2. Overall Survival (OS)

Source: https://euclinicaltrials.eu/ctis-public/view/2023-505102-42-00